EU clinical trial 2023-508726-10-00: A Phase 3, Randomized, Double-blind Study of Adjuvant Nivolumab versus Placebo for Participants with Hepatocellular Carcinoma Who Are at High Risk of Recurrence after Curative Hepatic Resection or Ablation (CheckMate 9DX: CHECKpoint pathway and nivoluMAb clinical Trial Evaluation 9DX)
Protocol code: CA209-9DX
Sponsor: Bristol-Myers Squibb Services Unlimited Company (Pharmaceutical company). Phase: Therapeutic confirmatory (Phase III). Countries: France (ongoing, recruitment ended), Austria (ongoing, recruitment ended), Germany (ongoing, recruitment ended), Netherlands (ongoing, recruitment ended), Spain (ongoing, recruitment ended), Romania (ongoing, recruitment ended), Belgium (ongoing, recruitment ended), Italy (ongoing, recruitment ended).
Therapeutic area(s): Diseases [C] - Neoplasms [C04]
Gender: Female, Male. Age: 18-64 years, 65+ years. Enrolment: 145.
Status: Ongoing, recruitment ended. Start date (EU): 2018-03-28. Decision date: 2024-02-22. Results received: No. Last updated: 2026-07-20.
Decision dates by country: RO: 2024-03-05, AT: 2024-04-08, DE: 2024-02-26, ES: 2024-02-26, FR: 2024-03-04, IT: 2024-02-26, NL: 2024-02-22, BE: 2024-02-27

Condition(s): Hepatocellular Carcinoma
Product: OPDIVO 10 mg/mL concentrate for solution for infusion., 5% Dextrose injection; Solution for injection/infusion, 0.9% Sodium Chloride injection; Solution for injection/infusion

Primary endpoint: Recurrence free survival (RFS), defined as the time from randomization to the first documented disease recurrence or death (by any cause), whichever occurs first.
Endpoint(s): OS, defined as the time between the date of randomization and the date of death (by any cause)., Time to Recurrence (TTR), defined as the time from randomization to the first documented disease recurrence.

Source: https://euclinicaltrials.eu/ctis-public/view/2023-508726-10-00